EU clinical trial 2024-513529-21-00: Basic Toolbox for Lipedema Syndrome Assessment ("BATOLISA")
Sponsor: Universite Libre de Bruxelles (Educational Institution). Phase: Therapeutic use (Phase IV). Countries: Belgium (ended).
Therapeutic area(s): Diseases [C] - Hemic and Lymphatic Diseases [C15]; Analytical, Diagnostic and Therapeutic Techniques and Equipment [E] - Diagnosis [E01]; Diseases [C] - Skin and Connective Tissue Diseases [C17]; Diseases [C] - Pathological Conditions, Signs and Symptoms [C23]; Phenomena and Processes [G] - Physiological processes [G07]
Gender: Female. Age: 18-64 years. Enrolment: 60.
Status: Ended. Start date (EU): 2025-01-24. End date (EU): 2026-01-16. Decision date: 2024-08-09. Results received: No. Last updated: 2024-12-20.

Condition(s): Lipedema, Lipoedema
Product: VERDYE 5 mg/ml poudre pour solution injectable

Primary endpoint: 1. To observe the fluorescence in the extracellular matrix surrounding the superficial lymphatic vessels.
Endpoint(s): To quantify the mean velocity of the bolus displacement between two reference points placed over the collectors 50mm apart., 2. To measure the occlusion pressure of the superficial lymphatic collectors (below 160mmHg).

Source: https://euclinicaltrials.eu/ctis-public/view/2024-513529-21-00